EU clinical trial 2022-501599-25-00: A multicenter, randomized open-label study to assess the efficacy, safety, and pharmacokinetics of upadacitinib with a tocilizumab reference arm in subjects from 1 year to less than 18 years old with active systemic juvenile idiopathic arthritis.
Protocol code: M14-682
Sponsor: Abbvie Deutschland GmbH & Co. KG (Pharmaceutical company). Phase: Therapeutic confirmatory (Phase III). Countries: Spain (authorised, recruiting), Sweden (authorised, recruiting), Germany (ongoing, recruiting), Belgium (ended), Italy (ongoing, recruiting), Austria (authorised, recruiting), Hungary (ongoing, recruiting), Netherlands (authorised, recruiting).
Therapeutic area(s): Diseases [C] - Immune System Diseases [C20]
Gender: Female, Male. Age: 0-17 years. Enrolment: 33.
Start date (EU): 2024-03-19. Decision date: 2023-11-22. Results received: No. Last updated: 2026-07-08.
Decision dates by country: BE: 2023-11-27, DE: 2023-11-23, HU: 2024-10-21, NL: 2024-11-18, SE: 2023-11-24, ES: 2023-11-27, IT: 2023-11-22, AT: 2024-11-11

Condition(s): juvenile idiopathic arthritis
Product: RoActemra 20 mg/mL concentrate for solution for infusion, RoActemra 162 mg solution for injection in pre-filled syringe., Upadacitinib, RoActemra 162 mg solution for injection in pre-filled pen., Upadacitinib

Primary endpoint: The primary endpoint only applies to Cohort 1. The primary endpoint is achievement of adapted sJIA ACR 30 response at Week 12 (defined as absence of fever [> 38°C] in the previous 1 week preceding evaluation and improvement of ≥ 30% in ≥ 3 of the 6 variables of the JIA core set [defined in Section 3.3], with no more than 1 variable worsening by > 30%).
Endpoint(s): The secondary endpoints only apply to Cohort 1. Secondary Endpoint(s) 1. Achievement of adapted sJIA ACR 50/70/90/100 response at Week 12 2. Change from Baseline in each core adapted sJIA ACR component at Week 12 · Number of joints with active arthritis · Number of joints with limitation of motion · Childhood Health Assessment Questionnaire-Disability Index (CHAQ-DI) · Patient/Parent Global Assessment (Pt/ParentGA) · Physician's global assessment of disease activity (PhGA) · High-sensitivity CRP

Source: https://euclinicaltrials.eu/ctis-public/view/2022-501599-25-00